EU clinical trial 2023-504993-40-00: A Phase 3b, multi-center, randomized, parallel-group, open-label, non-inferiority study evaluating the efficacy, safety, and tolerability of oral dolutegravir/lamivudine once-daily as a first-line regimen compared to oral bictegravir/emtricitabine/tenofovir alafenamide once daily for virologic suppression and maintenance in antiretroviral therapy naive adults living with HIV
Protocol code: 219816
Sponsor: Viiv Healthcare UK Limited (Pharmaceutical company). Phase: Therapeutic confirmatory (Phase III). Countries: Spain (ongoing, recruitment ended), Greece (ongoing, recruitment ended), Ireland (ongoing, recruitment ended), Portugal (ongoing, recruitment ended), Germany (ongoing, recruitment ended), Italy (ongoing, recruitment ended), France (ongoing, recruitment ended), Sweden (ongoing, recruitment ended), Poland (ongoing, recruitment ended), Denmark (ongoing, recruitment ended), Belgium (ongoing, recruitment ended).
Therapeutic area(s): Diseases [C] - Virus Diseases [C02]
Gender: Female, Male. Age: 18-64 years, 65+ years. Enrolment: 378.
Status: Ongoing, recruitment ended. Start date (EU): 2024-02-14. Decision date: 2024-01-22. Results received: No. Last updated: 2026-07-30.
Decision dates by country: IE: 2024-01-26, IT: 2024-01-23, PL: 2024-04-04, SE: 2024-04-04, FR: 2024-04-04, PT: 2024-01-25, DE: 2024-01-24, DK: 2024-04-04, BE: 2024-06-07, ES: 2024-01-22, GR: 2024-01-26

Condition(s): Human immunodeficiency virus (HIV)
Product: Biktarvy 50 mg/200 mg/25 mg film-coated tablets, Dovato 50 mg/300 mg film-coated tablets

Primary endpoint: Participant with plasma HIV-RNA <50 copies/mL as per Snapshot algorithm at Week 48
Endpoint(s): Participant with plasma HIV-1 RNA <50 c/mL (c/mL) at Weeks 96 as per the Snapshot algorithm, - Participant with HIV-RNA >/= 50 c/mL as per Snapshot algorithm at Week 48, and Week 96, - Change from Baseline in HIV-1 RNA (log10 c/mL) and CD4+ cell count and CD4/CD8 ratio over time through Week 48 and Week 96., - Occurrence of disease progression (HIVassociated conditionsAIDS and death) through Week 48 and Week 96.

Source: https://euclinicaltrials.eu/ctis-public/view/2023-504993-40-00